EU clinical trial 2023-510461-10-00: A study in healthy men and women to test whether BI 1569912 influences the amount of repaglinide, midazolam and bupropion in the blood
Protocol code: 1447-0007
Sponsor: Boehringer Ingelheim International GmbH (Pharmaceutical company). Phase: Human Pharmacology (Phase I)- Other. Countries: Belgium (ended).
Therapeutic area(s): Not possible to specify
Gender: Female, Male. Age: 18-64 years. Enrolment: 18.
Status: Ended. Start date (EU): 2024-05-07. End date (EU): 2024-08-20. Decision date: 2024-04-30. Results received: No. Last updated: 2024-04-30.

Condition(s): Healthy volunteer trial

Source: https://euclinicaltrials.eu/ctis-public/view/2023-510461-10-00